EU clinical trial 2024-510805-27-00: An open-label, multi-centre, rollover study to characterise long-term safety and efficacy of etavopivat in adults, adolescents and children who have sickle cell disease or thalassaemia and have completed a treatment period in an etavopivat study
Protocol code: NN7535-7822
Sponsor: Novo Nordisk A/S (Pharmaceutical company). Phase: Therapeutic confirmatory (Phase III). Countries: France (ongoing, recruiting), Italy (ongoing, recruiting), Greece (ongoing, recruiting), Spain (ongoing, recruiting), Germany (ongoing, recruiting).
Therapeutic area(s): Diseases [C] - Hemic and Lymphatic Diseases [C15]
Gender: Female, Male. Age: 0-17 years, 18-64 years, 65+ years. Enrolment: 44.
Status: Ongoing, recruiting. Start date (EU): 2025-01-09. Decision date: 2024-11-15. Results received: No. Last updated: 2026-08-07.
Decision dates by country: ES: 2024-11-22, GR: 2024-11-18, IT: 2024-11-19, FR: 2024-11-15, DE: 2024-11-18

Condition(s): Sickle Cell Disease and Thalassaemia
Product: Etavopivat A 200 mg

Primary endpoint: Number of TEAEs, reported for each indication and age group separately, Number of adverse reactions, reported for each indication and age group separately
Endpoint(s): Annualised VOC rates, reported for each age group separately, Change in VOCs, reported for each age group separately, Change in Hb concentration, reported for each age group separately, Annualised number of hospitalisations, reported for each age group separately, Average length of stay of hospitalisations, reported for each age group separately, Change in Hb concentration, Number of RBC units transfused, reported for each indication separately, Change in RBC units transfused, reported for each indication separately

Source: https://euclinicaltrials.eu/ctis-public/view/2024-510805-27-00